EU clinical trial 2024-512606-25-00: A Phase 1/2, Open-Label, Multi-Center, First-in-Human Study of the Safety, Tolerability, Pharmacokinetics, and Anti-Tumor Activity of TPX-0005 in Patients with Advanced Solid Tumors Harboring ALK, ROS1, or NTRK1-3 Rearrangements (TRIDENT-1)
Protocol code: TPX-0005-01
Sponsor: Turning Point Therapeutics Inc. (Pharmaceutical company). Phase: Phase I and Phase II (Integrated)- First administration to humans. Countries: Denmark (ended), Belgium (ended), Hungary (ended), Germany (ongoing, recruitment ended), France (ongoing, recruitment ended), Spain (ongoing, recruitment ended), Italy (ongoing, recruitment ended), Poland (ongoing, recruitment ended), Netherlands (ongoing, recruitment ended).
Therapeutic area(s): Diseases [C] - Neoplasms [C04]
Gender: Male. Age: 0-17 years, 18-64 years, 65+ years. Enrolment: 190.
Start date (EU): 2019-12-20. Decision date: 2024-07-19. Results received: No. Last updated: 2026-04-30.
Decision dates by country: DK: 2024-07-24, HU: 2024-07-19, NL: 2024-07-19, IT: 2024-08-05, DE: 2024-07-24, FR: 2024-07-26, ES: 2024-07-22, BE: 2024-07-23, PL: 2024-08-04

Condition(s): Advanced Solid Tumors
Product: Repotrectinib (TPX-0005)

Primary endpoint: Objective Response Rate (ORR) as assessed by BICR using RECIST Version 1.1, in each subject population expansion cohort of solid tumors that harbor a ROS1, NTRK1, NTRK2, or NTRK3 gene rearrangement.
Endpoint(s): 1. Duration of Response (DOR), 2. Time to Response (TTR), 3. Clinical Benefit Rate (CBR), 4. Intracranial Objective Response Rate, 5. CNS Progression-Free Survival (CNS-PFS), 6. Progression-Free Survival (PFS), 7. Overall Survival (OS)

Source: https://euclinicaltrials.eu/ctis-public/view/2024-512606-25-00